EU clinical trial 2024-511996-13-00: An open-label, randomized, Phase 3 clinical trial of IO102-IO103 in combination with pembrolizumab versus pembrolizumab alone in patients with previously untreated, unresectable, or metastatic (advanced) melanoma
Protocol code: IOB-013/KN-D18
Sponsor: Io Biotech ApS (Pharmaceutical company). Phase: Therapeutic confirmatory (Phase III). Countries: Hungary (ended), Denmark (ended), Poland (ended), Italy (ended), Belgium (ended), Spain (ended), France (ended), Germany (ended), Czechia (ended), Netherlands (ended).
Therapeutic area(s): Diseases [C] - Neoplasms [C04]
Gender: Female, Male. Age: 18-64 years, 65+ years. Enrolment: 327.
Status: Ended. Start date (EU): 2022-05-11. End date (EU): 2026-01-29. Decision date: 2024-04-30. Results received: Yes. Last updated: 2025-11-25.
Decision dates by country: HU: 2024-05-06, ES: 2024-04-30, BE: 2024-05-06, PL: 2024-05-06, CZ: 2024-05-03, IT: 2024-05-08, NL: 2024-04-30, DK: 2024-04-30, DE: 2024-05-03, FR: 2024-05-06

Condition(s): Previously untreated, unresectable, or metastatic melanoma
Product: KEYTRUDA 25 mg/mL concentrate for solution for infusion, IO102-IO103

Primary endpoint: • PFS, defined as the time from randomization to the first documented disease progression (based on Independent Review Committee (IRC) in accordance with RECIST v1.1) or death from any cause. Patients who have not progressed or died at the time of analysis will be censored at the date of assessment from their last disease assessment.
Endpoint(s): • Overall Response Rate (ORR) defined as the percentage of patients achieving a confirmed partial response (PR) or confirmed complete response (CR). ORR will be determined by the IRC in accordance with RECIST v1.1., • OS, defined as the time from randomization until death from any cause. Patients not known to have died will be censored at the date they were last known to be alive Etc.

Source: https://euclinicaltrials.eu/ctis-public/view/2024-511996-13-00